EU clinical trial 2022-501028-95-00: The ENACT Trial: A Randomized, double-blind, placebo-controlled adjunctive treatment trial to evaluate the efficacy and safety of ENX-101 in patients with focal (partial onset) seizures
Protocol code: ENX-101-005
Sponsor: Engrail Therapeutics Inc. (Pharmaceutical company). Phase: Therapeutic exploratory (Phase II). Countries: Germany (expired), Belgium (expired), Netherlands (expired), Spain (expired).
Therapeutic area(s): Diseases [C] - Nervous System Diseases [C10]
Gender: Female, Male. Age: 18-64 years. Enrolment: 72.
Status: Expired. Decision date: 2022-12-05. Results received: No. Last updated: 2022-12-13.
Decision dates by country: BE: 2022-12-12, DE: 2022-12-09, ES: 2022-12-13, NL: 2022-12-05

Condition(s): focal (partial onset) epilepsy
Product: ENX-101 Placebo Capsule, ENX-101, ENX-101, ENX-101, ENX-101 Placebo tablet

Primary endpoint: The responder rate defined as the percent of patients who experience a 50% or greater reduction from baseline in seizure frequency in the Treatment Period compared to placebo
Endpoint(s): The median percent change from baseline in 28-day focal seizure frequency (focal aware motor with observable component, focal impaired awareness, or focal to bilateral tonic-clonic seizures) compared to placebo, The percent of patients who are seizure free during the last 28 days of the Treatment Period, The percent of patients who are seizure free during the entire Treatment Period

Source: https://euclinicaltrials.eu/ctis-public/view/2022-501028-95-00